EU clinical trial 2025-523510-87-00: A Phase 3, Randomized, Double-Blind, Placebo-Controlled Study to Evaluate the Efficacy and Safety of KAI-9531 Administered Once Weekly in Participants Living with Obesity or Overweight and Diabetes
Protocol code: K9531-3104
Sponsor: Kailera Therapeutics Inc. (Pharmaceutical company). Phase: Therapeutic confirmatory (Phase III). Countries: Hungary (not authorised), Poland (ongoing, recruiting), Bulgaria (ongoing, recruiting), Germany (ongoing, recruiting), Czechia (ongoing, recruiting), Spain (ongoing, recruiting).
Therapeutic area(s): Diseases [C] - Nutritional and Metabolic Diseases [C18]
Gender: Female, Male. Age: 18-64 years, 65+ years. Enrolment: 626.
Start date (EU): 2026-06-25. Decision date: 2026-05-04. Results received: No. Last updated: 2026-05-18.
Decision dates by country: BG: 2026-05-18, CZ: 2026-05-07, DE: 2026-05-04, HU: 2026-05-15, ES: 2026-05-08, PL: 2026-05-15

Condition(s): Obesity
Product: Identical to kai-9531 solution for injection without active drug, KAI-9531, KAI-9531, KAI-9531

Primary endpoint: Percent change in body weight (kg) from baseline at Week 76. Change in hemoglobin A1c (%) from baseline at Week 76
Endpoint(s): Controlled for Type I error Percent change in body weight (kg) from baseline at Week 76, Controlled for Type I error Change in hemoglobin A1c (%) from baseline at Week 76, Percentage of participants with ≥5%, ≥10%, ≥15%, ≥20%, and ≥25% reduction in body weight (kg) • Change in waist circumference (cm) • Change in absolute weight (kg) • Percentage of participants with HbA1c <7% and ≤6.5% • Change in fasting blood glucose (mg/dL • Change in SBP (mm Hg) • Percent change in fasting: − Triglycerides (mg/dL) − HDL-cholesterol (mg/dL) − Non-HDL-cholesterol (mg/dL) • Change in IWQOL-Lite-CT physical function composite score, Controlled for Type I error: Percent change in body weight (kg) from baseline at Week 76 in subgroup of participants with BMI ≥35 kg/m2, Not controlled for Type I error:From baseline at Week 76:Percentage of participants with ≥30% reduction in body weight (kg).Change in BMI (kg/m2).Percentage of participants with HbA1c <5.7%.Change in DBP (mm Hg).Percent change in fasting:Total cholesterol (mg/dL)−LDL-cholesterol (mg/dL)−VLDL-cholesterol (mg/dL)−insulin (mIU/L).Change in Control of Eating Questionnaire (COEQ).Change (all KAI-9531 doses combined) in Food Noise Questionnaire (FNQ) score, Not controlled for Type I error: • Treatment-emergent adverse events (TEAEs), Not controlled for Type I error: • Antidrug antibodies (ADAs) • Neutralizing antibodies (NAbs), Not controlled for Type I error: Concentrations of KAI-9531

Source: https://euclinicaltrials.eu/ctis-public/view/2025-523510-87-00